EU clinical trial 2023-508266-15-00: Effects of Finerenone on Renal Hemodynamics and Oxidative Stress
Protocol code: FINE
Sponsor: Universitaetsklinikum Erlangen AöR (Hospital/Clinic/Other health care facility). Phase: Therapeutic confirmatory (Phase III). Countries: Germany (ended).
Therapeutic area(s): Diseases [C] - Nutritional and Metabolic Diseases [C18]
Gender: Female, Male. Age: 18-64 years, 65+ years. Enrolment: 75.
Status: Ended. Start date (EU): 2024-01-18. End date (EU): 2025-11-25. Decision date: 2023-12-19. Results received: No. Last updated: 2024-08-16.

Condition(s): type 2 diabetes mellitus
Product: Kerendia 10 mg film coated tablets, Placebo: film-coated tablet without active substance for oral use, AMINOHIPPURIC ACID, ACCUPAQUE™ 350 Injektionslösung oder Lösung zum Einnehmen, Kerendia 20 mg film-coated tablets, L-ARGININE HYDROCHLORIDE, Centricor® Vitamin C Ampullen 100 mg/ml Injektionslösung

Primary endpoint: Primary endpoint is to analyse the impact of finerenone on the oxidative stress level of renal vasculature by the increase of renal perfusion following vitamin C infusion compared to placebo

Source: https://euclinicaltrials.eu/ctis-public/view/2023-508266-15-00